EU clinical trial 2024-512978-99-00: AGAVE-201, A Phase 2, Open-label, Randomized, Multicenter Study to Evaluate the Efficacy, Safety and Tolerability of Axatilimab at 3 Different Doses in Patients with Recurrent or Refractory Active Chronic Graft Versus Host Disease who have Received at least 2 Lines of Systemic Therapy.
Protocol code: SNDX-6352-0504
Sponsor: Syndax Pharmaceuticals Inc. (Pharmaceutical company). Phase: Therapeutic exploratory (Phase II). Countries: Spain (ongoing, recruitment ended), France (ongoing, recruitment ended), Italy (ongoing, recruitment ended), Greece (ongoing, recruitment ended), Belgium (ongoing, recruitment ended), Germany (ongoing, recruitment ended).
Therapeutic area(s): Phenomena and Processes [G] - Immune system processes [G12]
Gender: Female, Male. Age: 0-17 years, 18-64 years, 65+ years. Enrolment: 67.
Status: Ongoing, recruitment ended. Start date (EU): 2021-07-19. Decision date: 2024-07-17. Results received: No. Last updated: 2026-07-06.
Decision dates by country: GR: 2024-07-22, ES: 2024-07-17, FR: 2024-07-23, IT: 2024-08-07, DE: 2024-07-19, BE: 2024-07-19

Condition(s): Chronic graft versus host disease (cGVHD)
Product: AXATILIMAB

Primary endpoint: 1. ORR in the first 6 cycles as defined by the 2014 National Institutes of Health (NIH) Consensus Development Project on Criteria for Clinical Trials in cGVHD
Endpoint(s): 1. mLSS, 2. - ORR, - DOR, - SRR, - Organ-specific and joints and fascia response rate, - Average daily corticosteroid dose, - Discontinue corticosteroid, - Average daily CNI dose, - Discontinue CNI., 3. - AEs and SAEs, - Vital signs, safety laboratory parameters, physical/neurological examination, ECG, and Karnofsky/Lansky performance scale., 4. PK parameters and patient factors., 5. CSF-1, IL-34 levels., 6. Circulating monocyte number and phenotype., 7. Baseline circulating monocyte number and phenotype.

Source: https://euclinicaltrials.eu/ctis-public/view/2024-512978-99-00